EU clinical trial 2022-500234-29-00: Efficacy of a sequential treatment strategy in Rheumatoid Arthritis. A randomized controlled trial with an independent efficacy assessor.
Protocol code: RECHMPL21_0568
Sponsor: Centre Hospitalier Universitaire De Montpellier (Hospital/Clinic/Other health care facility). Phase: Therapeutic confirmatory (Phase III). Countries: France (ongoing, recruiting).
Therapeutic area(s): Diseases [C] - Musculoskeletal Diseases [C05]; Diseases [C] - Immune System Diseases [C20]
Gender: Female, Male. Age: 18-64 years, 65+ years. Enrolment: 200.
Status: Ongoing, recruiting. Start date (EU): 2022-11-28. Decision date: 2022-07-12. Results received: No. Last updated: 2026-03-03.

Condition(s): Rheumatoid Arthritis
Product: ORENCIA 125 mg solution for injection in pre-filled syringe

Primary endpoint: Percentage of patients in remission defined by DAS28-CRP<2.6 score during the 36 weeks of treatment following randomization using a mixed logistic regression model for repeated data
Endpoint(s): Percentage of patients in remission using different definitions: DAS28-ESR<2.6, CDAI≤2.8, SDAI≤3.3 and Boolean criteria (number of tender and swollen joint, visual analogue scale for global health and CRP all ≤1), Percentage of patients in remission using different definitions at 12, 24 and 36 weeks after randomization: DAS28-ESR<2.6, CDAI≤2.8, SDAI≤3.3 and Boolean criteria (number of tender and swollen joint, visual analogue scale for global health and CRP all ≤1), Proportion of responders using EULAR definition (variations of DAS28-CRP from baseline >0.6 and DAS28-CRP≤5.1) at 12, 24 and 36 weeks after randomization, Values and variations from baseline of patient-reported outcomes including health-assessment questionnaire (HAQ-DI), EQ5D, SF-36 (SF-6D), Variation of auto-antibodies titles (RF and ACPA) and correlation of these variations with remission rate defined by DAS28-CRP<2.6, Frequency of flares assessed using the FLARE-RA questionnaire completed by the patient between visits, Cumulative doses of steroids collected with a booklet between 12 weeks and 48 weeks visits, Safety: rates of serious adverse events including severe infections between randomization visit (W12) and 48 weeks, Cost efficacy analysis based on direct and indirect costs and QALY between randomization visit (W12) and 48 weeks, Variations Sharp modified by Van der Heidje score between baseline and 48 weeks, Percentage of patients remaining on abatacept in the sequential arm and on the 1st TNF inhibitor in the control arm at 48 weeks

Source: https://euclinicaltrials.eu/ctis-public/view/2022-500234-29-00